EU clinical trial 2024-514138-19-00: A phase II study to evaluate the imaging potential of 68GaNOTA-Anti-MMR VHH2 for in vivo imaging of MMR-expressing Macrophages by means of Positron Emission Tomography (PET) in patients with non-small cell lung cancer (NSCLC).
Sponsor: UZ Brussel (Hospital/Clinic/Other health care facility). Phase: Therapeutic exploratory (Phase II). Countries: Belgium (ongoing, recruiting).
Therapeutic area(s): Diseases [C] - Neoplasms [C04]
Gender: Female, Male. Age: 18-64 years, 65+ years. Enrolment: 20.
Status: Ongoing, recruiting. Start date (EU): 2023-02-15. Decision date: 2024-10-28. Results received: No. Last updated: 2026-07-29.

Condition(s): Patients with non-small cell lung cancer
Product: 68Ga-UZBRU-VHH2

Primary endpoint: Immunohistological MMR score on excised tissue

Source: https://euclinicaltrials.eu/ctis-public/view/2024-514138-19-00